EU clinical trial 2023-510354-16-00: Using lymph nOde fine needle aspiration to assess the effeCt of pnEumococcal vAcciNe platform, Age and HIV infection on Germinal cEntre formation (OCEAN-AGE)
Protocol code: 2023-510354-16-00
Sponsor: Academisch Ziekenhuis Leiden (Hospital/Clinic/Other health care facility). Phase: Phase III and phase IV (Integrated). Countries: Netherlands (ongoing, recruiting).
Therapeutic area(s): Phenomena and Processes [G] - Immune system processes [G12]
Gender: Female, Male. Age: 18-64 years, 65+ years. Enrolment: 75.
Status: Ongoing, recruiting. Start date (EU): 2025-03-06. Decision date: 2025-01-27. Results received: No. Last updated: 2025-01-31.
Decision dates by country: NL: 2025-01-31

Condition(s): HIV infection
Product: Prevenar 20 suspension for injection in pre-filled syringe Pneumococcal polysaccharide conjugate vaccine (20-valent, adsorbed), PNEUMOVAX 23 ενέσιμο διάλυμα σε προγεμισμένη σύριγγαΠολυσακχαριδικό Εμβόλιο Πνευμονιόκοκκου

Primary endpoint: Immunophenotyping of lymph node FNA samples (% germinal centre B cells and %T follicular helper cells), 4 weeks after vaccination.
Endpoint(s): Immunophenotyping of PBMC's 6 months after vaccination (% S. pneumoniae PS-specific B cells per serotype, Spn PS-specific B cell phenotype, Spn PS-specific antibody titres, Spn PS-specific antibody fuctionality, CRM-197 specific B cells and T cells., Serum and lymph node supernatant biomarkers at day 7, day 28 and day 72 post vaccination, Immunophenotyping and functional analysis of PBMCs at baseline, Serum biomarkers at baseline., Pneumococcal serotype specific colonisation in saliva, lymph node size in cortical thickness, long axis and short axis (determined by ultrasound), Comparing Spn PS-specific antibody titres in saliva to Spn PS-specific antibody titres in peripheral blood., Association between diet, excercise, alcohol consumption, smoking, comorbidities, medication, clinical Frailty score, CD4+ T cell count and immune response (% Bgc cells and Tfh cells, 4 weeks after vaccination)., Pneumococcal serotype specific colonisation in saliva and its association with post vaccination serotype specific B cells, serotype specific antibody response and OPA-titres in peripheral blood.

Source: https://euclinicaltrials.eu/ctis-public/view/2023-510354-16-00